EU clinical trial 2023-505634-94-00: A 2-Part Seamless Part A (Phase 2)/ Part B (Phase 3) Randomized, Double-Blind, Placebo-Controlled, Multicenter Study to Evaluate the Efficacy and Safety of BIIB059 in Participants with Active Subacute Cutaneous Lupus Erythematosus and/or Chronic Cutaneous Lupus Erythematosus with or without Systemic Manifestations and Refractory and/or Intolerant to Antimalarial Therapy (AMETHYST)
Protocol code: 230LE301
Sponsor: Biogen Idec Research Limited (Pharmaceutical company). Phase: Phase II and Phase III (Integrated). Countries: Bulgaria (ongoing, recruitment ended), Poland (ongoing, recruitment ended), Sweden (ended), Italy (ended), Spain (ongoing, recruitment ended), Hungary (ongoing, recruitment ended), Germany (ongoing, recruitment ended), Slovakia (ended), Portugal (ongoing, recruitment ended), France (ongoing, recruitment ended), Belgium (ongoing, recruitment ended).
Therapeutic area(s): Diseases [C] - Immune System Diseases [C20]
Gender: Female, Male. Age: 18-64 years, 65+ years. Enrolment: 217.
Start date (EU): 2023-02-02. Decision date: 2024-03-19. Results received: No. Last updated: 2026-03-25.
Decision dates by country: BE: 2025-09-08, HU: 2024-03-19, BG: 2024-04-23, PL: 2024-03-26, PT: 2024-03-19, SE: 2024-03-20, SK: 2024-03-19, ES: 2024-03-21, IT: 2024-03-21, FR: 2024-03-22, DE: 2024-03-20

Condition(s): Subacute Cutaneous Lupus Erythematosus, Chronic Cutaneous Lupus Erythematosus
Product: BIIB059 placebo is a sterile liquid for injection. The formulation composition of the placebo is identical to that of BIIB059 drug product minus the active ingredient., BIIB059

Primary endpoint: Parts A (US+ROW) and B (US): Percentage of Participants who Achieve a Cutaneous Lupus Activity of Physician’s Global Assessment-Revised (CLA-IGA-R) Erythema Score of 0 or 1. Time frame: Week 16., Part B (ROW): Percentage of Participants who Achieve Cutaneous Lupus Erythematosus Disease Area and Severity Index Activity Score (CLASI-70) Response, Defined as ≥ 70% Decrease in CLASI-A Score From Baseline. Time frame: baseline to Week 24.
Endpoint(s): Part A (US+ROW): Percentage of Participants who Achieve a CLASI-50 Response, Defined as a ≥ 50%Decrease in CLASI-A Score From Baseline Time frame: Weeks 16 and 24., Part A (US+ROW): Absolute Change From Baseline in Cutaneous Lupus Erythematosus Disease Area and Severity Index Damage (CLASI-D) Score at Week 52. Time frame: Baseline to Week 52., Part B (US+ROW): Percentage of Participants who Achieve a CLA-IGA-R Erythema Score of 0 or 1, at Week 16 and Week 24, Respectively, for Participants in Full Analysis Set (FAS), who had CLA-IGA-R Erythema Score ≥3 and OMC Score ≥3 at Baseline. Time frame: Weeks 16 and 24., Part B (US+ROW): Percentage of Participants who Achieve a CLA-IGA-R OMC Score of 0 or 1, at Week 16 and Week 24, Respectively, for Participants in FAS, who had CLA-IGA-R Erythema Score ≥3and OMC Score ≥3 at Baseline. Time frame: Weeks 16 and 24., Part B (US+ROW): Percentage of Participants who Achieve at Least 1 Level of Improvement From Baseline in the CLA-IGA-R Erythema Score. Time frame: Up to Week 24., Part B (US+ROW): Absolute Change in CLASI-D Score. Time frame: Week 52., Part B (US+ROW): Percent Change in CLASI-D Score. Time frame: Week 52., Part B (US+ROW): Change From Baseline in Cutaneous Lupus Erythematosus-Quality of Life (CLE-QoL) Score. Time frame: Part B (US): Weeks 16 and 52; Part B (ROW): Weeks 24 and 52., Part B (US+ROW): Change From Baseline in Dermatology Life Quality Index (DLQI) Score. Time frame: Part B (US): Weeks 16 and 52; Part B (ROW): Weeks 24 and 52., Parts A (US+ROW) and B (US): Percentage of Participants who Achieve a CLASI-70 Response, Defined as a ≥ 70% Decrease in CLASI-A Score From Baseline. Time frame: Part A (US+ROW): Weeks 16 and 24; Part B (US): Week 16., Parts A and B (US+ROW): Percentage of Participants who Achieve a CLA-IGA-R Erythema Score of 0 or 1. Time frame: Part A (US+ROW): Week 24; Part B (ROW): Week 24; Part B (US+ROW): Up to Week 24., Parts A and B (US+ROW): Percentage of Participants who Achieve a CLA-IGA-R Other Morphologic Characteristics (OMC) Score of 0 or 1 and at Least 1 Level of Improvement From Baseline. Time frame: Part A (US+ROW): Weeks 16 and 24; Part B (US): Week 16; Part B (ROW): Week 24; Part B (US+ROW):Up to Week 24., Parts A and B (US+ROW): Percentage of Participants who Achieve a CLA-IGA-R OMC Score of 0. Time frame: Part A (US+ROW): Weeks 16 and 24; Part B (US+ROW): Up to Week 24., Parts A and B (US+ROW): Percentage of Participants With at Least 1 Level of Improvement From Baseline in CLA-IGA-R OMC Score. Time frame: Part A (US+ROW): Weeks 16 and 24; Part B (US+ROW): Up to Week 24., Parts A and B (US+ROW): Percentage of Participants who Achieve a CLA-IGA-R Follicular Activity Score of 0. Time frame: Parts A and B (US+ROW): Weeks 16 and 24; Part B (US+ROW): Up to Week 24., Parts A and B (US+ROW): Percentage of Participants who Achieve a CLASI-A Score of 0 or 1. Time frame: Up to Week 24., Parts A and B (US+ROW): Percentage of Participants who Achieve a CLASI-A Score of 0 to 3. Time frame: Up to Week 24., Parts A and B (US+ROW): Percentage of Participants who Achieve a 70% Reduction in CLASI-A. Time frame: Up to Week 24., Parts A and B (US+ROW): Percentage of Participants who Achieve a 50% Reduction in CLASI-A. Time frame: Up to Week 24., Parts A and B (US+ROW): Percentage of Participants who Achieve a 7-Point Reduction From Baseline in CLASI-A Score. Time frame: Up to Week 24., Parts A and B (US+ROW): Percentage of Participants With a CLASI-70 Response at Week 52 AmongCLASI-70 Responders at Week 16 and Week 24, Respectively, who Were Randomly Assigned to Receive Litifilimab During the DBPC Treatment Period (TP). Time frame: Week 52., Parts A and B (US+ROW): Percentage of Participants With CLA-IGA-R Erythema Score of 0 or 1 at Week 52 Among CLA-IGA-R Erythema Responders at Week 16 and Week 24, Respectively, who Were Randomly Assigned to Receive BIIB059 During the DBPC TP. Time frame: Week 52., Parts A and B(US+ROW):Percentage of Participants With CLA-IGA-R OMC Score of 0/1 and at Least 1 Level of Improvement From Baseline at Week 52 Among CLA-IGA-R OMC Responders at Weeks 16and 24, Respectively, who Were Assigned to Receive Litifilimab in DBPC TP. Time frame: Week 52., Parts A and B (US+ROW): Percentage of Participants With CLA-IGA-R OMC Score of 0 at Week 52 Among CLA-IGA-R OMC Responders With CLA-IGA-R OMC Score of 0 at Week 16 and Week 24, Respectively, who Were Randomly Assigned to Litifilimab During the DBPC TP. Time frame: Week 52., Parts A and B(US+ROW):Percentage of Participants With CLA-IGA-R Follicular Activity Score of 0 at Week 52 Among CLA-IGA-R Follicular Activity Responders at Week 16 and Week 24, Respectively, who Were Randomly Assigned to Receive Litifilimab in DBPC TP. Time frame: Week 52., Parts A and B (US+ROW): Percentage of Participants With a CLASI-70 Response at Week 52 AmongCLASI-70 Nonresponders at Week 16 and Week 24, Respectively, who Were Randomly Assigned to Receive Placebo During the DBPC TP. Time frame: Week 52., Parts A and B (US+ROW): Percentage of Participants With a CLA-IGA-R Erythema Score of 0 or 1 at Week 52 Among CLA-IGA-R Erythema Nonresponders at Week 16 and Week 24, Respectively, who Were Randomly Assigned to Receive Placebo During the DBPC TP. Time frame: Week 52., Parts A, B(US+ROW):Percentage of Participants With CLA-IGA-R OMC Score of 0/1 and at Least 1Level of Improvement From Baseline at Week 52 Among CLA-IGA-R OMC Nonresponders at Weeks16 and 24, Respectively, who Were Assigned to Receive Placebo in DBPC TP. Time frame: Week 52., Parts A and B (US+ROW): Percentage of Participants With a CLA-IGA-R OMC Score of 0 at Week 52Among CLA-IGA-R OMC Nonresponders at Week 16 and Week 24, Respectively, who Were Randomly Assigned to Receive Placebo During the DBPC TP. Time frame: Week 52., Parts A and B(US+ROW): Percentage of Participants who Achieve CLA-IGA-R Follicular Activity Score of 0 at Week 52 Among CLA-IGA-R Follicular Activity Nonresponders at Weeks 16 and 24,Respectively, who Were Randomly Assigned to Receive Placebo in DBPC TP. Time frame: Week 52., Parts A and B (US+ROW): Annualized Mild and Moderate Safety of Estrogens in Lupus Erythematosus National Assessment-SLE Disease Activity Index Flare Index (SFI) Rate and Annualized Severe SFI Rate Through Week 24. Time frame: Up to Week 24., Parts A and B (US+ROW): Annualized Mild and Moderate SFI Rate and Annualized Severe SFI Rate Through Week 16. Time frame: Up to Week 16., Parts A and B (US+ROW): Annualized Mild and Moderate SFI Rate and Annualized Severe SFI Rate Through Week 52. Time frame: Up to Week 52., Parts A and B (US+ROW): Number of Participants Experiencing Treatment Emergent Adverse Events (TEAEs) and Serious Adverse Events (SAEs). Time frame: Up to Week 76., Percent Change in CLASI-D Score. Time Frame: Baseline to Week 52., Part B (US+ROW): Change From Baseline in Numerical Rating Scale (NRS) for Pain in Skin Rash. Time Frame: Part B (US): Weeks 16 and 52; Part B (ROW): Weeks 24 and 52., Part B (US+ROW): Change From Baseline in NRS for Itch in Skin Rash. Time Frame: Part B (US): Weeks 16 and 52; Part B (ROW): Weeks 24 and 52., Parts A and B (US+ROW): Percentage of Participants who Achieve a CLASI 70 Response. Time Frame: Up to Week 24., Parts A and B (US+ROW): Number of Participants With Anti-Litifilimab Antibodies in Serum During the Study. Time Frame: Up to Week 76

Source: https://euclinicaltrials.eu/ctis-public/view/2023-505634-94-00